EU clinical trial 2024-515706-77-00: A Phase 3 Multicenter, Randomized, Double-blind, Placebo-controlled and Ustekinumab Active Comparator-controlled Study to Evaluate the Efficacy and Safety of JNJ-77242113 for the Treatment of Participants With Moderate to Severe Plaque Psoriasis
Protocol code: 77242113PSO3006
Sponsor: Janssen Cilag International (Pharmaceutical company). Phase: Therapeutic confirmatory (Phase III). Countries: Hungary (ongoing, recruitment ended), Spain (ongoing, recruitment ended), Belgium (ongoing, recruitment ended), Germany (ongoing, recruitment ended), Denmark (ongoing, recruitment ended), Austria (ended), Poland (ongoing, recruitment ended), Portugal (ongoing, recruitment ended).
Therapeutic area(s): Diseases [C] - Immune System Diseases [C20]
Gender: Female, Male. Age: 0-17 years, 18-64 years, 65+ years. Enrolment: 434.
Start date (EU): 2025-05-08. Decision date: 2025-05-06. Results received: No. Last updated: 2026-05-18.
Decision dates by country: AT: 2025-05-12, DE: 2025-05-06, PL: 2025-05-13, PT: 2025-05-19, BE: 2025-05-08, ES: 2025-05-07, HU: 2025-05-07, DK: 2025-05-06

Condition(s): Moderate to Severe Plaque Psoriasis
Product: Solution for injection in pre-filled syringe without Ustekinumab 90, Solution for injection without Ustekinumab 45, STELARA 45 mg solution for injection, STELARA 90 mg solution for injection in pre-filled syringe, JNJ-77242113, Film-Coated Tablet without JNJ-77242113

Primary endpoint: IGA score of 0 or 1 and a ≥2 grade improvement from baseline at Week 16., PASI 90 at Week 16.

Source: https://euclinicaltrials.eu/ctis-public/view/2024-515706-77-00